EU clinical trial 2024-512174-10-00: Post-resection/ ablation chemotherapy in patients with metastatic colorectal cancer (FIRE-9 - PORT / AIO-KRK-0418). Prospective, randomized, open, multicenter Phase III trial to investigate the efficacy of active post-resection/ ablation therapy in patients with metastatic colorectal cancer.
Protocol code: FIRE-9 - PORT
Sponsor: Charite Universitaetsmedizin Berlin KöR (Hospital/Clinic/Other health care facility). Phase: Therapeutic confirmatory (Phase III). Countries: Germany (ongoing, recruiting).
Therapeutic area(s): Diseases [C] - Digestive System Diseases [C06]
Gender: Female, Male. Age: 18-64 years, 65+ years. Enrolment: 507.
Status: Ongoing, recruiting. Start date (EU): 2021-11-11. Decision date: 2024-11-13. Results received: No. Last updated: 2026-07-21.

Condition(s): metastatic colorectal cancer
Product: FLUOROURACIL, IRINOTECAN HYDROCHLORIDE TRIHYDRATE, CAPECITABINE, CALCIUM FOLINATE PENTAHYDRATE, OXALIPLATIN, DISODIUM FOLINATE

Primary endpoint: Progression-free survival (PFS) time at the 24 months follow-up defined as time from randomization to death or evidence of disease (whatever occurs first)

Source: https://euclinicaltrials.eu/ctis-public/view/2024-512174-10-00